EU clinical trial 2023-506177-35-00: A Phase 3, Randomized, Double-Blind Study of Pembrolizumab versus Placebo in Combination With Paclitaxel With or Without Bevacizumab for the Treatment of Platinum-resistant Recurrent Ovarian Cancer (KEYNOTE-B96 / ENGOT-ov65).
Protocol code: MK-3475-B96
Sponsor: Merck Sharp & Dohme LLC (Pharmaceutical company). Phase: Phase III and phase IV (Integrated). Countries: Finland (ended), Germany (ongoing, recruitment ended), Italy (ongoing, recruitment ended), Denmark (ended), France (ongoing, recruitment ended), Norway (ended), Ireland (ended), Netherlands (ongoing, recruitment ended), Poland (ongoing, recruitment ended), Belgium (ongoing, recruitment ended).
Therapeutic area(s): Diseases [C] - Neoplasms [C04]
Gender: Female. Age: 18-64 years, 65+ years. Enrolment: 209.
Start date (EU): 2021-10-23. Decision date: 2023-08-08. Results received: No. Last updated: 2026-06-16.
Decision dates by country: IE: 2023-08-08, DK: 2023-08-09, FI: 2023-08-09, BE: 2023-08-18, NO: 2023-08-11, PL: 2023-08-22, FR: 2023-08-10, DE: 2023-08-10, NL: 2023-08-10, IT: 2023-08-10

Condition(s): Ovarian, fallopian tube, or primary peritoneal carcinoma.
Product: BEVACIZUMAB, Normal saline or dextrose, DOCETAXEL, KEYTRUDA 25 mg/mL concentrate for solution for infusion, PACLITAXEL

Primary endpoint: Progression-free Survival (PFS) per Response Evaluation Criteria in Solid Tumors 1.1 (RECIST 1.1) by Investigator.
Endpoint(s): Overall Survival (OS)., PFS per RECIST 1.1 by Blinded Independent Central Review (BICR)., Number of Participants who Experience an Adverse Event (AE)., Number of Participants who Discontinue Study Treatment due to an AE., Change From Baseline in Global Health Status/Quality of Life (GHS/Qol) Score (Items 29 and 30) Using the European Organization for Research and Treatment of Cancer Quality of Life Questionnaire-Core 30 (EORTC QLQ-C30), Time to Deterioration (TTD) in the GHS/Qol Score (Items 29 and 30) Using the EORTC QLQ-C30., Change From Baseline in the Abdominal and Gastrointestinal (GI) Symptoms Score (Items 31 to 36) Using the EORTC Quality of Life Questionnaire-Ovarian Cancer (QLQ-OV28) Abdominal/GI Symptom Scale., TTD in the Abdominal and GI Symptoms Score (Items 31 to 36) Using the EORTC QLQ-OV28 Abdominal/GI Symptom Scale.

Source: https://euclinicaltrials.eu/ctis-public/view/2023-506177-35-00